EU clinical trial 2024-517829-12-00: A Master Protocol for the Multi-cohort, Open-label, Phase 1/2 Study of DCC-3084 as Monotherapy and in Combination With Other Anticancer Agents in Participants With Advanced Malignancies Driven by the MAPK Pathway
Protocol code: DCC-3084-01-001
Sponsor: Deciphera Pharmaceuticals Inc. (Pharmaceutical company). Phase: Phase I and Phase II (Integrated)- First administration to humans. Countries: Germany (ended), France (ended), Spain (ended).
Therapeutic area(s): Diseases [C] - Neoplasms [C04]
Gender: Female, Male. Age: 18-64 years, 65+ years. Enrolment: 60.
Status: Ended. End date (EU): 2025-09-12. End date: 2026-02-13. Decision date: 2025-06-26. Results received: No. Last updated: 2025-08-18.
Decision dates by country: DE: 2025-07-01, ES: 2025-06-30, FR: 2025-06-26

Condition(s): Solid tumors driven by the MAPK Pathway
Product: DCC-3084, DCC-3084

Primary endpoint: Part 1: Number of Participants with Dose-limiting Toxicities (DLTs), Part 2: Objective Response Rate (ORR); ORR is the percentage of participants with confirmed complete or partial remission based on indication specific criteria as defined in the protocol.
Endpoint(s): 1. Part 1: ORR (the percentage of participants with confirmed complete or partial remission based on indication specific criteria as defined in the protocol), 2. Part 1 and 2: Progression-Free Survival (PFS). PFS is the time from start of therapy to PD or death due to any cause., 3. Part 1 and 2: Overall Survival (OS). OS is the time from start of therapy to death from any cause., 4. Part 1 and 2: Pharmacokinetics (PK): Maximum observed plasma drug concentration (Cmax)

Source: https://euclinicaltrials.eu/ctis-public/view/2024-517829-12-00